EU clinical trial 2024-513033-21-00: Long-Term Follow-Up (LTFU) of Participants Treated with Adoptive Cell Therapies
Protocol code: 208750/04
Sponsor: USWM Ct LLC (Pharmaceutical company). Phase: Human Pharmacology (Phase I)- Other. Countries: Netherlands (authorised, recruitment pending), Spain (ongoing, recruiting), Italy (authorised, recruiting).
Therapeutic area(s): Diseases [C] - Neoplasms [C04]
Gender: Female, Male. Age: 0-17 years, 18-64 years, 65+ years. Enrolment: 5.
Start date (EU): 2020-09-14. Decision date: 2024-07-11. Results received: No. Last updated: 2026-05-08.
Decision dates by country: IT: 2024-08-05, NL: 2024-07-12, ES: 2024-07-11

Condition(s): Non-small cell lung cancer (NSCLC), Synovial sarcoma, Multiple Myeloma & other indications, Myxoid/round cell liposarcoma (MRCLS)
Product: GSK3377794

Primary endpoint: AEs/SAEs to be reported: New malignancies, AEs/SAEs to be reported: New incidence or exacerbation of a pre-existing neurologic disorder, AEs/SAEs to be reported: New incidence or exacerbation of a prior rheumatologic or other autoimmune disorder, AEs/SAEs to be reported: New incidence of hematologic disorder, AEs/SAEs to be reported: New incidence of infection (potentially related to gene modified cell therapy), AEs/SAEs to be reported: Unanticipated illness and/or hospitalization deemed related to gene modified cell therapy
Endpoint(s): Vesicular Stomatitis Virus G protein (VSV-G) deoxyribonucleic acid (DNA) copies in peripheral blood samples., Woodchuck hepatitis virus posttranscriptional regulatory element (WPRE) or Psi DNA copies in peripheral blood samples, Integrated vector sequences and vector integration patterns (e.g., polyclonal, oligoclonal, or monoclonal) identified in peripheral blood, Incidence of death and time to death

Source: https://euclinicaltrials.eu/ctis-public/view/2024-513033-21-00